EU clinical trial 2023-506285-31-00: An Open-label Dose-Escalation Study to Evaluate XmAb24306 as a Single Agent and in Combination with Atezolizumab in Patients with Locally Advanced or Metastatic Solid Tumors
Protocol code: GO41596
Sponsor: Genentech Inc. (Pharmaceutical company). Phase: Human Pharmacology (Phase I)- First administration to humans. Countries: Netherlands (ended), Belgium (ended), Spain (ended), Italy (ended).
Therapeutic area(s): Diseases [C] - Neoplasms [C04]
Gender: Female, Male. Age: 18-64 years, 65+ years. Enrolment: 99.
Status: Ended. Start date (EU): 2021-04-21. End date (EU): 2026-05-22. End date: 2026-05-28. Decision date: 2024-04-15. Results received: No. Last updated: 2026-05-26.
Decision dates by country: BE: 2024-04-22, ES: 2024-04-22, NL: 2024-04-15, IT: 2024-05-13

Condition(s): Locally Advanced or Metastatic Solid Tumors

Source: https://euclinicaltrials.eu/ctis-public/view/2023-506285-31-00